EU clinical trial 2024-518886-89-00: Phase II randomized study on efficacy of nintedanib for treatment of epistaxis in hereditary haemorrhagic telangiectasia (HHT) patients - EPISTOP
Protocol code: 69HCL23_1299
Sponsor: Hospices Civils De Lyon (Hospital/Clinic/Other health care facility). Phase: Therapeutic exploratory (Phase II). Countries: France (ongoing, recruitment ended).
Therapeutic area(s): Diseases [C] - Congenital, Hereditary, and Neonatal Diseases and Abnormalities [C16]
Gender: Female, Male. Age: 18-64 years, 65+ years. Enrolment: 28.
Status: Ongoing, recruitment ended. Start date (EU): 2025-06-16. Decision date: 2025-05-06. Results received: No. Last updated: 2025-11-03.

Condition(s): Hereditary haemorrhagic telangiectasia
Product: Ofev 150 mg soft capsules, This will be provided by the product owner

Primary endpoint: Proportion of patients with at least 30% reduction of monthly epistaxis duration after 16 weeks of study treatment (at V6, week 24) compared to baseline (V1, week 8) assessed in nintedanib arm and in placebo arm., The monthly epistaxis duration after 16 weeks of study treatment is defined as the average of epistaxis duration during the last 12 weeks of study treatment (minutes/4-weeks period averaged for weeks 12 to 24, i.e. V3 to V6), The monthly epistaxis duration at baseline is defined as the average of epistaxis duration during the observation period (minutes/4-weeks period averaged for weeks 0 to 8, i.e. V0 to V1).

Source: https://euclinicaltrials.eu/ctis-public/view/2024-518886-89-00